EU clinical trial 2022-502481-24-00: A Phase 2b, Randomized, Double-Blind, Placebo-Controlled, Multicenter Study of the Efficacy and Safety of Brensocatib in Participants with Chronic Rhinosinusitis Without Nasal Polyps – The BiRCh Study
Protocol code: The BiRCh Study
Sponsor: Insmed Inc. (Pharmaceutical company). Phase: Therapeutic exploratory (Phase II). Countries: Bulgaria (ended), Czechia (ended), Denmark (ended), Spain (ended), Portugal (ended), Belgium (ended), France (ended), Poland (ended), Germany (ended), Italy (ended), Hungary (ended).
Therapeutic area(s): Diseases [C] - Respiratory Tract Diseases [C08]
Gender: Female, Male. Age: 18-64 years, 65+ years. Enrolment: 203.
Status: Ended. Start date (EU): 2024-05-23. End date (EU): 2025-10-29. End date: 2025-10-30. Decision date: 2024-02-06. Results received: No. Last updated: 2025-05-14.
Decision dates by country: HU: 2024-02-06, IT: 2024-05-08, BG: 2024-02-09, ES: 2024-02-08, DE: 2024-02-08, DK: 2024-02-06, BE: 2024-02-06, PT: 2024-02-06, PL: 2024-05-07, CZ: 2024-02-06, FR: 2024-02-09

Condition(s): Chronic Rhinosinusitis without Nasal Polyps (CRSsNP)
Product: BRENSOCATIB, MOMETASONE, BRENSOCATIB, The placebo used the same excipients as that used in IMP without active drug substance. The placebo was developed as film-coated tablet same in size and appearance to the IMP.

Primary endpoint: Change from Baseline to the 28-day average of daily Sinus Total Symptom Score (sTSS)a at Week 24
Endpoint(s): Change from Baseline in percentage of sinus (maxillary and ethmoid) opacification as measured by volumetry at Week 24, Change from Baseline in modified Lund-MacKay (LMK) CT score at Week 24, Participant status indicator for requiring rescue (antibiotics, SCS, and/or nasal surgery) due to worsening of any CRS symptom, Change from Baseline to the 28-day average of daily Nasal Congestion Scores (NCS) at Weeks 24, Change from Baseline to the 28-day average of daily Peak Nasal Inspiratory Flow (PNIF) at Week 24, Change from Baseline in Sino-Nasal Outcome Test (SNOT-22) at Week 24, Brensocatib plasma concentration, Adverse events (AEs) over 24 weeks of treatment, Clinical laboratory test results, vital signs, and electrocardiograms (ECGs) over 24 weeks of treatment

Source: https://euclinicaltrials.eu/ctis-public/view/2022-502481-24-00